EU clinical trial 2025-525073-37-00: A study to investigate the safety, tolerability, pharmacokinetics, immunogenicity and pharmacodynamics of a single subcutaneous dose of GSK4771261 in healthy participants aged 25 to 55 years of age inclusive
Protocol code: 221377
Sponsor: Glaxosmithkline Research & Development Limited (Pharmaceutical company). Phase: Human Pharmacology (Phase I)- Other. Countries: Netherlands (temporarily halted).
Therapeutic area(s): Diseases [C] - Congenital, Hereditary, and Neonatal Diseases and Abnormalities [C16]
Gender: Female, Male. Age: 18-64 years. Enrolment: 30.
Status: Temporarily halted. Start date (EU): 2026-05-12. Decision date: 2026-05-06. Results received: No. Last updated: 2026-05-06.

Condition(s): Autosomal Dominant Polycystic Kidney Disease

Source: https://euclinicaltrials.eu/ctis-public/view/2025-525073-37-00